EU clinical trial 2023-506687-13-00: A Randomized, Double-blind, Placebo-controlled, Multicenter Study to Evaluate the Efficacy and Safety of Cenobamate Adjunctive Therapy in Subjects with Primary Generalized Tonic-Clonic Seizures
Protocol code: YKP3089C025
Sponsor: Sk Life Science Inc. (Pharmaceutical company). Phase: Therapeutic confirmatory (Phase III). Countries: Slovakia (ended), Hungary (ended), Spain (ended), Poland (ended), Germany (ended).
Therapeutic area(s): Diseases [C] - Nervous System Diseases [C10]
Gender: Female, Male. Age: 0-17 years, 18-64 years, 65+ years. Enrolment: 84.
Status: Ended. Start date (EU): 2019-01-31. End date (EU): 2025-05-26. End date: 2025-05-27. Decision date: 2024-07-02. Results received: Yes. Last updated: 2025-04-02.
Decision dates by country: HU: 2024-07-02, SK: 2024-07-02, DE: 2024-07-03, PL: 2024-08-04, ES: 2024-07-02

Condition(s): Primary Generalized Tonic-Clonic Seizures
Product: Cenobamate 50mg, Cenobamate 100mg, Cenobamate 10mg/mL, Placebo matching with 12.5mg, 25mg, 50mg, 100mg cenobamate tablets and 10mg/mL cenobamate oral suspension unit strength, Cenobamate 25mg, Cenobamate 12.5mg

Primary endpoint: The primary efficacy endpoint will include: 1. USA and Rest of the World (RoW): median percent change from baseline in PGTC seizure frequency per 28-day interval during the Double-blind treatment period., The primary efficacy endpoint will include: 2. Europe, South Africa, Australia, and New Zealand: 50% responder rate for PGTC seizures during the Maintenance Phase. A responder is defined as a subject who achieves at least a 50% reduction in PGTC seizure frequency per 28-day interval during the Maintenance Phase relative to baseline.
Endpoint(s): The secondary efficacy endpoints will include: 1. 100% responder rates for PGTC seizures during the Maintenance Phase relative to baseline., 2. 75% responder rates for PGTC seizures during the Maintenance Phase relative to baseline., 3. Percentage of subjects who achieved a 50% reduction in all generalized seizures frequency per 28-day period during the Maintenance Phase relative to baseline., The secondary safety endpoints will include adverse events and concomitant medication reporting, clinical laboratory results, vital signs, electrocardiograms (ECGs), physical examinations, neurologic examinations, and Columbia Suicide Severity Rating Scale (C-SSRS) results will be summarized using descriptive statistics., The secondary pharmacokinetic endpoints will include: 1. Summary of individual patients’ plasma concentrations of cenobamate at their respective doses and visits., 2. Population PK analysis will be performed on data available from this study alone or integrated with data from other cenobamate studies. The population PK analysis results will be reported separately. In addition, a population PK/pharmacodynamic analysis may be conducted as a stand-alone approach for PGTC or in combination with POS data, if deemed appropriate.

Source: https://euclinicaltrials.eu/ctis-public/view/2023-506687-13-00